EU clinical trial 2025-524470-41-00: GRAIN, Prospective Pilot Study
Protocol code: UMCG #21252
Sponsor: Universitair Medisch Centrum Groningen (Hospital/Clinic/Other health care facility). Phase: Human Pharmacology (Phase I)- First administration to humans. Countries: Netherlands (authorised, recruiting).
Therapeutic area(s): Diseases [C] - Neoplasms [C04]
Gender: Female, Male. Age: 18-64 years, 65+ years. Enrolment: 52.
Status: Authorised, recruiting. Start date (EU): 2026-07-29. Decision date: 2026-06-01. Results received: No. Last updated: 2026-07-27.

Condition(s): Esophageal dysplasia, Barrett's esophagus, Esophageal adenocarcinoma

Source: https://euclinicaltrials.eu/ctis-public/view/2025-524470-41-00